EU clinical trial 2023-506865-71-00: An adaptive open-label multicentre phase 1/2 trial, to determine the recommended phase 2 dose of CCTx-001, and to assess safety, tolerability, and clinical activity in patients with relapsed/refractory acute myeloid leukaemia (RESOLVE AML 001)
Protocol code: CCTx-001-AML-001
Sponsor: CanCell Therapeutics (Pharmaceutical company). Phase: Phase I and Phase II (Integrated)- First administration to humans. Countries: Germany (authorised, recruitment pending), Spain (authorised, recruitment pending), Sweden (authorised, recruitment pending), France (authorised, recruitment pending).
Therapeutic area(s): Diseases [C] - Neoplasms [C04]; Diseases [C] - Hemic and Lymphatic Diseases [C15]
Gender: Female, Male. Age: 18-64 years, 65+ years. Enrolment: 61.
Status: Authorised, recruitment pending. Decision date: 2024-02-26. Results received: No. Last updated: 2024-09-27.
Decision dates by country: ES: 2024-02-26, DE: 2024-02-28, FR: 2024-03-04, SE: 2024-03-01

Condition(s): Relapsed/Refractory Acute Myeloid Leukemia (AML)
Product: CYCLOPHOSPHAMIDE MONOHYDRATE, FLUDARABINE PHOSPHATE

Primary endpoint: Phase 1 - Frequency, severity, relationship and persistence of AEs and DLTs, Phase 2 - Composite complete response rate (cCRR) defined as the proportion of patients with best overall response, as assessed by IRC based on ELN 2022 criteria, at complete remission (CR), CR with partial haematologic recovery (CRh), or CR with incomplete haematologic recovery (CRi).
Endpoint(s): Phase 1 - Composite complete response rate (cCRR) defined as the proportion of patients with best overall response, as assessed by IRC based on ELN 2022 criteria, at complete remission (CR), CR with partial haematologic recovery (CRh), or CR with incomplete haematologic recovery (CRi)., Phase 2 - Complete remission rate (CRR) defined as the proportion of patients with best overall response, as assessed by IRC based on ELN 2022 criteria, at CR., Phase 2 - Frequency, severity, relationship and persistence of AEs, Phase 2 - Changes in HRQoL using global health/QoL, fatigue, physical and cognitive functioning subscales of the EORTC QLQ-C30, and the HM-PRO tools, Phase 1 & 2 - Objective response rate (ORR), event-free survival (EFS), relapse-free survival (RFS), overall survival (OS), duration of response (DOR), cumulative incidence of relapse (CIR), cumulative incidence of death (CID), time to composite complete response (TTcCR), and time to response (TTR) according to ELN 2022 criteria, and MRD responses, Phase 1 & 2 -Frequency and severity of AEs and laboratory abnormalities

Source: https://euclinicaltrials.eu/ctis-public/view/2023-506865-71-00